EU clinical trial 2024-513296-41-00: Randomized phase II study of PAnitumumab REchallenge followed by REgorafenib versus the reverse sequence in RAS and BRAF wild-type chemorefractory metastatic colorectal cancer patients. The PARERE trial
Protocol code: PARERE
Sponsor: Fondazione GONO G.I. (Patient organisation/association). Phase: Therapeutic exploratory (Phase II). Countries: Italy (ended).
Therapeutic area(s): Diseases [C] - Neoplasms [C04]
Gender: Female, Male. Age: 18-64 years, 65+ years. Enrolment: 214.
Status: Ended. Start date (EU): 2020-12-03. End date (EU): 2026-05-28. Decision date: 2024-09-16. Results received: Yes. Last updated: 2026-06-03.

Condition(s): Colorectal cancer spread at distance, RAS BRAF wild type pretreatted
Product: Vectibix 20 mg/ml concentrate for solution for infusion, Stivarga 40 mg film-coated tablets

Primary endpoint: The primary endpoint is Overall Survival. OS is defined as the time from randomization to the date of death due to any cause. For patients still alive at the time of analysis, the OS time will be censored on the last date the patients were known to be alive
Endpoint(s): Overall Toxicity Rate is defined as the percentage of patients, relative to the total of enrolled subjects, experiencing any adverse event, according to National Cancer Institute Common Toxicity Criteria (version 5.0), during panitumumab and regorafenib, G3/4 Toxicity Rate is defined as the percentage of patients, relative to the total of enrolled subjects, experiencing a specific adverse event of grade 3/4, according to National Cancer Institute Common Toxicity Criteria (version 5.0), during panitumumab and regorafenib., 1st-Progression free survival (1st-PFS) is defined as the time from randomization to the first documentation of objective disease progression or death due to any cause, whichever occurs first., 2nd-Progression free survival (2nd-PFS) is defined as the time from the beginning of the second-line study treatment to the documentation of objective disease progression according to RECIST 1.1 criteria or death due to any cause, whichever occurs first., Time to Failure of strategy (TFS) is defined as the time from randomization till the first of any of the following events: a) death; b) disease progression according to RECIST 1.1 criteria on any treatment given after 1st progression. For patients that will not receive any treatment within 3 months after 1st progression, TFS will be equal to PFS., Objective Response Rate (ORR) is defined as the percentage of patients, relative to the total of enrolled subjects, achieving a complete (CR) or partial (PR) response, according to RECIST 1.1 criteria, during panitumumab and regorafenib. The determination of clinical response will be based on investigator reported measurements. Responses will be evaluated every 8 weeks

Source: https://euclinicaltrials.eu/ctis-public/view/2024-513296-41-00